EU clinical trial 2024-515581-13-00: Isatuximab in combination with Lenalidomide-Dexamethasone compared to Lenalidomide-Dexamethasone in elderly patients (aged ≥70 years) with newly diagnosed myeloma: a randomized phase II study (SGZ-2019-12650)
Protocol code: AGMT_MM-4
Sponsor: Arbeitsgemeinschaft Medikamentoese Tumortherapie gGmbH (Hospital/Clinic/Other health care facility). Phase: Therapeutic exploratory (Phase II). Countries: Austria (ongoing, recruitment ended), Greece (ongoing, recruitment ended).
Therapeutic area(s): Diseases [C] - Neoplasms [C04]
Gender: Female, Male. Age: 65+ years. Enrolment: 138.
Status: Ongoing, recruitment ended. Start date (EU): 2021-10-20. Decision date: 2024-10-11. Results received: No. Last updated: 2025-10-27.
Decision dates by country: AT: 2024-11-08, GR: 2024-10-11

Condition(s): Isatuximab in combination with Lenalidomide-Dexamethasone compared to Lenalidomide-Dexamethasone in elderly patients (aged ≥70 years) with newly diagnosed myeloma: a randomized phase II study (SGZ-2019-12650)
Product: SARCLISA 20mg/mL concentrate for solution for infusion.

Primary endpoint: To evaluate the proportion of patients with MRD negativity (defined by NGF (next generation flow) at 10^-5) after end of induction treatment in the two arms.
Endpoint(s): To evaluate the Overall Response Rate (ORR), Partial Response (PR), Very Good Partial Response (VGPR) and Complete Response (CR) as per International Myeloma Working Group (IMWG) criteria in each arm., To compare the Progression-free (PFS) and Overall Survival (OS) between the two arms., To evaluate the proportion of patients with MRD negativity (defined by NGF at 10^-5) after 12 months (13 cycles) of maintenance treatment., To evaluate the Time to Progression (TTP) in each arm., To evaluate the PFS in high risk cytogenetic population defined as patients carrying a) del(17p), t(4;14), t(14;16) in each arm and b) the same aberrations plus amp1q21., To evaluate the Duration of Response in each arm., To evaluate safety in both treatment arms., To assess disease-specific and a generic health-related quality of life (HRQL), disease and treatment-related symptoms, health state utility and health status., To evaluate PFS of potential second line therapy.

Source: https://euclinicaltrials.eu/ctis-public/view/2024-515581-13-00